EU clinical trial 2024-516832-82-00: Treatment of patients with relapsed or refractory CD19+ lymphoid disease with T lymphocytes transduced by RV-SFG.CD19.CD28.4-BBzeta retroviral vector – A unicenter Phase I/II clinical trial [HD-CAR-1]
Sponsor: Universitaetsklinikum Heidelberg AöR (Hospital/Clinic/Other health care facility). Phase: Phase I and Phase II (Integrated)- Other. Countries: Germany (ongoing, recruiting).
Therapeutic area(s): Diseases [C] - Hemic and Lymphatic Diseases [C15]
Gender: Female, Male. Age: 0-17 years, 18-64 years, 65+ years. Enrolment: 63.
Status: Ongoing, recruiting. Start date (EU): 2018-08-27. Decision date: 2024-09-19. Results received: No. Last updated: 2024-09-19.

Condition(s): Accute lymphoblastic leukemia recurrent, Non-Hodgkin´s lymphoma NOS refractory
Product: CD19.CAR T cells

Primary endpoint: Assessment of toxicities according to the CTCAEv5.0, Assessment of frequency and grade of CRS and/or ICANS, Assessment of dose-limiting toxicity (DLT) and maximum tolerated dose (MTD), Yield of sufficient NCs by leukapheresis, Successful transduction (>15%) of CD3+ TCs, Yield of the respective dose of transduced TCs (1 to 20x106 transduced CD3+TCs/m2) in the first three dose levels (I-III), Yield of the respective dose of transduced TCs (5 to 20x107 transduced CD3+ TCs/m2) in the second three dose levels (IV-VI)
Endpoint(s): Evaluation of survival and function of chimeric antigen receptor (CAR) TCs directed against CD19 (CD19.CAR TC) in vivo, Characterization of in vivo cellular pharmakokinetics, Correlation of clinical response and number of circulating gene modified cells, Reduction of disease burden with CD19.CAR TC transfusions, Anti-tumor efficacy of CD19.CAR TCs in patients with CD19+ lymphoid disease (overall response rate (ORR), complete response (CR), partial response (PR)) at day 90 (EOS) after CD19.CAR TC transfusion), Time to response (at least PR) after the CD19.CAR TC transfusion, Duration of overall response (DOR) after the CD19.CAR TC transfusion, Progression-free survival (PFS) after the CD19.CAR TC transfusion, Overall survival (OS) after the CD19.CAR TC transfusion, Correlation of B-cell depletion in vivo and response to CD19.CAR TC treatment

Source: https://euclinicaltrials.eu/ctis-public/view/2024-516832-82-00